EU clinical trial 2025-520566-22-00: C4551002 - An Interventional, Open-Label, Randomized, Multicenter, Phase 3 Study of PF-07248144 Plus Fulvestrant Compared to Investigator’s Choice of Therapy in Adult Participants with Hormone Receptor-Positive, HER2-Negative Advanced/Metastatic Breast Cancer Whose Disease Progressed After Prior CDK4/6 Inhibitor-based Therapy
Protocol code: C4551002
Sponsor: Pfizer Inc. (Pharmaceutical company). Phase: Therapeutic confirmatory (Phase III). Countries: Hungary (authorised, recruiting), Bulgaria (ongoing, recruiting), Czechia (ongoing, recruiting), Slovakia (ongoing, recruiting), Netherlands (ongoing, recruiting), Spain (ongoing, recruiting), Greece (ongoing, recruiting), Finland (ongoing, recruiting), Belgium (ongoing, recruiting), Sweden (ongoing, recruiting), Poland (ongoing, recruiting), Germany (ongoing, recruiting), France (authorised, recruiting), Italy (ongoing, recruiting).
Therapeutic area(s): Diseases [C] - Neoplasms [C04]
Gender: Female, Male. Age: 18-64 years, 65+ years. Enrolment: 153.
Start date (EU): 2025-11-10. Decision date: 2025-10-20. Results received: No. Last updated: 2026-04-14.
Decision dates by country: CZ: 2025-10-20, FI: 2025-10-21, BG: 2025-10-27, PL: 2025-10-26, ES: 2025-10-27, IT: 2025-10-27, SE: 2025-10-22, HU: 2025-10-22, SK: 2025-10-20, BE: 2025-10-21, GR: 2025-10-22, FR: 2025-10-23, NL: 2025-10-27, DE: 2025-10-21

Condition(s): Hormone Receptor-Positive, HER2-Negative Advanced/Metastatic Breast Cancer
Product: EVEROLIMUS, EVEROLIMUS, PF-07248144, FULVESTRANT, EVEROLIMUS, EXEMESTANE, FULVESTRANT, PF-07248144

Primary endpoint: PFS, defined as the time from the date of randomization to the date of first documented disease progression, as determined by blinded independent central review (BICR) per RECIST v1.1, or death due to any cause in the absence of progressive disease (PD), whichever occurs first.
Endpoint(s): OS, defined as the time from the date of randomization to the date of death due to any cause., Objective Response (OR) by BICR per RECIST v1.1, DoR by BICR per RECIST v1.1, Clinical Benefit Response (CBR: complete response [CR], partial response [PR], or stable disease [SD] /non-CR/non-progression [non-PD] ≥24 weeks) by BICR per RECIST v1.1, Type, incidence, severity (as graded by the National Cancer Institute Common Terminology Criteria for Adverse Events [NCI CTCAE v5.0]), seriousness of adverse events (AEs), any laboratory test or electrocardiogram (ECG) abnormalities, and characterization PF-07248144 effect on corrected QT interval (QTc) from baseline., Ctrough (lowest plasma concentration before scheduled dose) of PF-07248144

Source: https://euclinicaltrials.eu/ctis-public/view/2025-520566-22-00